EU clinical trial 2023-506267-33-00: A Phase 1b/2 Study of JNJ-90014496 in Adult Participants with B-cell Non-Hodgkin Lymphoma
Protocol code: 90014496LYM1001
Sponsor: Janssen - Cilag International (Pharmaceutical company). Phase: Human Pharmacology (Phase I)- Other. Countries: Spain (ongoing, recruitment ended), Netherlands (ongoing, recruitment ended), Germany (not authorised), France (ended), Denmark (ongoing, recruitment ended), Italy (ended).
Therapeutic area(s): Diseases [C] - Neoplasms [C04]
Gender: Female, Male. Age: 18-64 years, 65+ years. Enrolment: 103.
Start date (EU): 2024-05-29. Decision date: 2024-04-30. Results received: No. Last updated: 2026-05-11.
Decision dates by country: DE: 2024-05-06, FR: 2024-04-30, DK: 2024-05-17, IT: 2026-01-20, ES: 2024-05-03, NL: 2024-04-30

Condition(s): Non-Hodgkin Lymphoid Malignancies

Source: https://euclinicaltrials.eu/ctis-public/view/2023-506267-33-00